EU clinical trial 2023-504991-31-00: A Phase 3, multicenter, randomized, double-blind, placebo-controlled study to assess the efficacy, safety, and tolerability of AVP-786 (deudextromethorphan hydrobromide [d6-DM]/quinidine sulfate [Q]) for the treatment of agitation in patients with dementia of the Alzheimer’s type
Protocol code: 20-AVP-786-307
Sponsor: Otsuka Pharmaceutical Development & Commercialization Inc. (Pharmaceutical company). Phase: Therapeutic confirmatory (Phase III). Countries: Spain (ended), Slovenia (ended), Hungary (ended), Belgium (ended), Slovakia (ended), Netherlands (ended), Ireland (ended), Croatia (ended).
Therapeutic area(s): Diseases [C] - Nervous System Diseases [C10]
Gender: Female, Male. Age: 18-64 years, 65+ years. Enrolment: 248.
Status: Ended. Start date (EU): 2021-05-06. End date (EU): 2024-05-22. End date: 2024-05-23. Decision date: 2024-04-25. Results received: Yes. Last updated: 2024-04-29.
Decision dates by country: BE: 2024-04-29, HR: 2024-04-29, HU: 2024-04-26, IE: 2024-04-25, SI: 2024-04-26, ES: 2024-04-25, NL: 2024-04-26, SK: 2024-04-26

Condition(s): Agitation in Patients With Dementia of the Alzheimer's Type
Product: AVP-786 matching placebo, AVP-786

Primary endpoint: The primary efficacy endpoint is the change from baseline to the end of the efficacy period in the CMAI total score.
Endpoint(s): The key secondary efficacy variable is the change from baseline to end of efficacy period in the CGI-S score, as related to agitation. It will be analyzed by the same statistical methodology specified for the analysis of the primary efficacy variable. The procedure to control the overall type I error rate for this key secondary efficacy analysis will be described in the SAP.

Source: https://euclinicaltrials.eu/ctis-public/view/2023-504991-31-00